EU clinical trial 2024-516095-15-00: A study to evaluate the safety, tolerability, pharmacokinetics and pharmacodynamics of GSK4771261 in healthy participants and participants with autosomal dominant polycystic kidney disease.
Protocol code: 221362
Sponsor: Glaxosmithkline Research & Development Limited (Pharmaceutical company). Phase: Human Pharmacology (Phase I)- First administration to humans. Countries: Germany (temporarily halted), France (temporarily halted), Netherlands (temporarily halted), Spain (temporarily halted), Belgium (temporarily halted).
Therapeutic area(s): Diseases [C] - Congenital, Hereditary, and Neonatal Diseases and Abnormalities [C16]
Gender: Female, Male. Age: 18-64 years. Enrolment: 21.
Status: Temporarily halted. Start date (EU): 2025-08-05. Decision date: 2025-04-30. Results received: No. Last updated: 2026-07-13.
Decision dates by country: NL: 2025-04-30, ES: 2025-04-30, FR: 2025-04-30, DE: 2025-05-02, BE: 2025-05-05

Condition(s): Kidney Disease

Source: https://euclinicaltrials.eu/ctis-public/view/2024-516095-15-00